EU clinical trial 2023-506226-36-00: IMPACT – the introduction of mycotic prophylaxis at cystectomy trial. Perioperative mycotic prophylaxis to reduce postoperative complications following cystectomy – a double-blinded, placebo-controlled, randomized trial.
Sponsor: Rigshospitalet (Hospital/Clinic/Other health care facility). Phase: Therapeutic use (Phase IV). Countries: Denmark (ongoing, recruiting).
Therapeutic area(s): Diseases [C] - Bacterial Infections and Mycoses [C01]
Gender: Female, Male. Age: 18-64 years, 65+ years. Enrolment: 420.
Status: Ongoing, recruiting. Start date (EU): 2024-06-23. Decision date: 2024-02-16. Results received: No. Last updated: 2026-05-19.
Decision dates by country: DK: 2024-06-14

Condition(s): Fungal infection
Product: Fluconazole Kabi 2mg/ml solution for infusion, Natriumklorid ”B. Braun”

Primary endpoint: Postoperative complications measured by Clavien Dindo III-V classification score
Endpoint(s): Days Alive and Out of Hospital measured within the 90th postoperative day, Time to gastrointestinal function (first bowel movement) postoperatively, Reduction in percentage of patients who require placement of nasogastric tube postoperatively, Quality of Life measured by questionnaires (EORTC QLQ-C30 and QLQ-BLM30) at day 0 and day 90, Length of stay for index admission, Re-admission within 30 and 90 days, Microbiome resistance development in the urinary tract, Urinary tract infections requiring treatment

Source: https://euclinicaltrials.eu/ctis-public/view/2023-506226-36-00